EU clinical trial 2022-503055-26-00: A Phase 1/2, Open-label Trial to Evaluate Safety, Immunogenicity, and Anti-tumor Activity of VB10.16 in Combination with Pembrolizumab in Patients with Unresectable Recurrent or Metastatic HPV16-positive Head and Neck Squamous Cell Carcinoma
Protocol code: VB-C-03
Sponsor: Nykode Therapeutics ASA (Pharmaceutical company). Phase: Phase I and Phase II (Integrated)- Other. Countries: Norway (ongoing, recruiting), Poland (ongoing, recruiting), Hungary (ongoing, recruiting), Germany (authorised, recruiting), France (ongoing, recruiting), Czechia (ended), Spain (ongoing, recruiting).
Therapeutic area(s): Diseases [C] - Neoplasms [C04]
Gender: Female, Male. Age: 18-64 years, 65+ years. Enrolment: 78.
Start date (EU): 2023-10-30. Decision date: 2023-07-11. Results received: No. Last updated: 2026-08-05.
Decision dates by country: CZ: 2023-07-12, NO: 2023-07-17, HU: 2023-07-17, PL: 2023-07-17, FR: 2023-07-11, ES: 2023-07-11, DE: 2023-07-14

Condition(s): Unresectable recurrent or metastatic HPV16 (Human Papilloma Virus) positive oropharyngeal Head and Neck Squamous Cell Carcinoma
Product: KEYTRUDA 25 mg/mL concentrate for solution for infusion

Primary endpoint: Dose Escalation Phase 1: Proportion of patients with DLTs (42-day DLT period), Randomized Phase 2: Objective response rate (ORR), Randomized Phase 2: Progression-free survival (PFS)
Endpoint(s): Randomized Phase 2: Disease control rate (DCR), Randomized Phase 2: Duration of response (DOR), Randomized Phase 2: Time to response (TTR), Randomized Phase 2: Progression-free survival (PFS) rate at 6, 12 and 24 months, Randomized Phase 2: Overall survival (OS), Randomization Phase 2: Overall survival (OS) rate at 6, 12 and 24 months, Randomized Phase 2: Restricted mean duration of response (RMDOR) at 6, 12 and 24 months, Randomized Phase 2: Proportion of patients who experience 1 or more TEAEs assessed by severity grade and relationship, Randomized Phase 2: Proportion of patients who discontinue trial treatment due to a TRAE, Dose Escalation Phase 1: Proportion of patients who experience 1 or more treatment-emergent adverse events (TEAEs) assessed by severity grade, Dose Escalation Phase 1: Proportion of patients who discontinue trial treatment due to a treatment-related adverse event (TRAE), Dose Escalation Phase 1: Change from baseline in HPV16 E6/E7-specific T-cell responses as measured by IFN-γ ELISpot in post-vaccination samples

Source: https://euclinicaltrials.eu/ctis-public/view/2022-503055-26-00